EU clinical trial 2023-508057-19-00: DESTINY-Biliary Tract Cancer-01: A Phase 3 Study of Trastuzumab Deruxtecan (T-DXd) and Rilvegostomig versus Standard-of-Care Gemcitabine, Cisplatin, and Durvalumab for First Line Locally Advanced or Metastatic HER2-expressing Biliary Tract Cancer.
Protocol code: D781PC00001
Sponsor: AstraZeneca AB (Pharmaceutical company). Phase: Therapeutic confirmatory (Phase III). Countries: Czechia (ongoing, recruiting), Germany (ongoing, recruiting), Belgium (ongoing, recruiting), Italy (ongoing, recruiting), Spain (ongoing, recruiting), Poland (ongoing, recruiting), Netherlands (not authorised), Slovakia (ongoing, recruiting), Austria (authorised, recruiting), France (ongoing, recruiting).
Therapeutic area(s): Diseases [C] - Neoplasms [C04]
Gender: Female, Male. Age: 18-64 years, 65+ years. Enrolment: 144.
Start date (EU): 2025-09-23. Decision date: 2025-05-23. Results received: No. Last updated: 2026-07-28.
Decision dates by country: NL: 2025-06-02, DE: 2025-05-27, BE: 2025-05-26, IT: 2025-05-30, ES: 2025-05-23, PL: 2025-06-01, SK: 2025-05-27, AT: 2025-06-02, CZ: 2025-05-27, FR: 2025-08-20

Condition(s): Advanced HER2-expressing Biliary Tract Cancer
Product: INFLIXIMAB, IMFINZI 50 mg/mL concentrate for solution for infusion., GEMCITABINE, CISPLATIN, Rilvegostomig, MYCOPHENOLATE MOFETIL, DS-8201a

Primary endpoint: To evaluate the efficacy of T-DXd with rilvegostomig vs Standard of Care in terms of Overall Survival in the FAS (HER2 IHC 3+) population
Endpoint(s): To evaluate the efficacy of T-DXd with rilvegostomig vs SoC in terms of OS in the FAS population (HER2 IHC 3+/2+)., To evaluate the efficacy of T-DXd monotherapy vs SoC in terms of OS in the FAS (HER2 IHC 3+) and FAS (HER2 IHC 3+/2+) populations., To further evaluate efficacy of T‑DXd with rilvegostomig or in monotherapy vs SoC in terms of PFS in the FAS (HER2 IHC 3+) and FAS (HER2 IHC 3+/2+) populations., To further evaluate the efficacy of T-DXd with rilvegostomig or in monotherapy vs SoC in terms of ORR in the FAS (HER2 IHC 3+) and FAS (HER2 IHC 3+/2+) populations., To further evaluate efficacy of T‑DXd with rilvegostomig or in monotherapy vs SoC in terms of DoR in patients with HER2‑expressing BTC in the FAS (HER2 IHC 3+) and FAS (HER2 IHC 3+/2+) populations., To further evaluate the efficacy of T-DXd with rilvegostomig versus T-DXd monotherapy in terms of OS, PFS, DoR and ORR in FAS (HER2 IHC 3+) and FAS (HER2 IHC 3+/2+) populations., To assess the safety and tolerability of T‑DXd with rilvegostomig or in monotherapy vs SoC., To assess the safety and tolerability of TDXd with rilvegostomig vs T-DXd monotherapy., To describe patient-reported tolerability of TDXd with rilvegostomig or in monotherapy in comparison to SoC based on a summary of symptomatic AEs and overall side-effect bother., To describe patient-reported tolerability of TDXd with rilvegostomig in comparison to T-DXd monotherapy based on a summary of symptomatic AEs and overall side-effect bother., To assess time to deterioration in physical functioning in patients treated with T-DXd with rilvegostomig or in monotherapy vs SoC., To assess time to deterioration in physical functioning in patients treated with T-DXd with rilvegostomig vs T-DXd monotherapy., To assess the PK of T-DXd, total anti-HER2 antibody, DXd and rilvegostomig in serum., To investigate the immunogenicity of T-DXd and of rilvegostomig.

Source: https://euclinicaltrials.eu/ctis-public/view/2023-508057-19-00